EU clinical trial 2024-511164-92-00: A Phase 2/3, Multicenter, randOmized, Double-blind, placebo-controlled, stUdy to evaLuate the safety and efficacy of Alpha-1 AntiTrypsin for the prEvention of graft versus-host disease in patients receiving hematopoietic cell transplant (MODULAATE Study)
Protocol code: CSL964_2001
Sponsor: CSL Behring LLC (Pharmaceutical company). Phase: Phase II and Phase III (Integrated). Countries: Spain (ended), Italy (ended), Germany (ended).
Therapeutic area(s): Phenomena and Processes [G] - Immune system processes [G12]
Gender: Female, Male. Age: 0-17 years, 18-64 years, 65+ years. Enrolment: 55.
Status: Ended. Start date (EU): 2019-05-17. End date (EU): 2026-01-12. End date: 2026-03-19. Decision date: 2024-05-22. Results received: No. Last updated: 2025-10-21.
Decision dates by country: DE: 2024-05-23, ES: 2024-05-22, IT: 2024-06-10

Condition(s): Acute Graft versus host disease
Product: Respreeza 1,000 mg powder and solvent for solution for infusion., Albumin solution administered intravenously

Primary endpoint: The time to Grade II-IV aGVHD or death through 180 days after hematopoietic cell transplantation (HCT).
Endpoint(s): Proportion of subjects with lower GI aGVHD or Grade III-IV aGVHD in any organ. Through 180 days after HCT., Proportion of subjects with severe infections defined by NCI-CTCAE ≥ Grade 3. Through Day 60 after HCT., Proportion of subjects with Grade II-IV aGVHD or death. Through 100 and 180 days after HCT., Proportion of subjects with lower GI aGVHD. Through Days 60, 100 and 180 after HCT., Deaths (relapse and nonrelapse-related). Within 180, 365, and 730 days after HCT., Proportion of subjects with severe infections defined by NCI-CTCAE ≥ Grade 3. Through 100 and 180 days after HCT., Proportion of subjects with Grade III-IV aGVHD or death. Through Days 60, 100, and 180 days after HCT., Proportion of subjects with moderate-to-severe chronic GVHD. Within 180, 365, 545, and 730 days after HCT., Proportion of subjects who have discontinued immune suppression therapies including standard-of-care GVHD prophylaxis and steroid treatment. Within 180 and 365 days after HCT., Time to neutrophil engraftment. Through 365 days after HCT., Time to GVHD relapse-free survival. Within 365 and 730 days after HCT., Proportion of subjects with relapse of primary malignancies. Through 180, 365, and 730 days after HCT., Proportion of subjects with Grade II-IV aGVHD with an overall (complete + partial) response, complete response and partial response. Approximately 4 weeks after the initiation of systemic steroids during 8-week Treatment Period, Percent of subjects with study drug-related adverse events. Up to 365 days after HCT., Maximum concentration (Cmax) of AAT. Before and up to 72 after infusion of AAT., Area under the concentration curve for AAT. Before and up to 72 after infusion of AAT., Clearance of AAT. Before and up to 72 after infusion of AAT., Volume of distribution for AAT. Before and up to 72 after infusion of AAT., Ctrough of AAT. Before and up to 72 after infusion of AAT.

Source: https://euclinicaltrials.eu/ctis-public/view/2024-511164-92-00